EU clinical trial 2025-520915-14-00: Satisfaction study of split doses botulinum toxin with double frequency
Protocol code: 14031972
Sponsor: Falck clinic (Hospital/Clinic/Other health care facility). Phase: Phase II and Phase III (Integrated). Countries: Netherlands (authorised, recruiting).
Therapeutic area(s): Phenomena and Processes [G] - Biological Phenomena [G16]; Phenomena and Processes [G] - Physical Phenomena [G01]; Diseases [C] - Skin and Connective Tissue Diseases [C17]
Gender: Female, Male. Age: 18-64 years. Enrolment: 52.
Status: Authorised, recruiting. Start date (EU): 2023-01-12. Decision date: 2025-01-29. Results received: No. Last updated: 2025-06-10.

Condition(s): Wrinkles, fine lines
Product: Bocouture 100 eenheden poeder voor oplossing voor injectie, Placebo to NT201

Primary endpoint: Difference between the intervention and control group in change from baseline eVAS Satisfaction Scale - Overall Satisfaction Score at Visit 6 (follow-up).
Endpoint(s): Adverse events.

Source: https://euclinicaltrials.eu/ctis-public/view/2025-520915-14-00